EU clinical trial 2024-513060-26-00: An open-label, multi-centre, phase I/IIa study evaluating the safety and clinical activity of neoantigen reactive T cells in patients with advanced non-small cell lung cancer
Protocol code: ATX-NS-001
Sponsor: Achilles Therapeutics UK Limited (Pharmaceutical company). Phase: Phase I and Phase II (Integrated)- First administration to humans. Countries: Spain (ended), Germany (ended), France (ended).
Therapeutic area(s): Diseases [C] - Neoplasms [C04]
Gender: Female, Male. Age: 18-64 years, 65+ years. Enrolment: 24.
Status: Ended. Start date (EU): 2021-04-07. End date (EU): 2024-09-17. End date: 2024-09-18. Decision date: 2024-06-03. Results received: Yes. Last updated: 2024-06-10.
Decision dates by country: FR: 2024-06-07, DE: 2024-06-10, ES: 2024-06-03

Condition(s): Non-small cell lung cancer
Product: KEYTRUDA 25 mg/mL concentrate for solution for infusion, ATL001

Primary endpoint: Frequency and severity of adverse events (AEs) and serious adverse events (SAEs) following tissue procurement and administration of lymphodepletion agents, ATL001 (monotherapy or in combination with pembrolizumab) and IL-2.
Endpoint(s): Percentage change from baseline in tumour size at 6 weeks, 12 weeks and best change from baseline, Overall Response Rate (ORR) (based on RECIST v1.1 and imRECIST), Time to response (based on RECIST v1.1 and imRECIST), Duration of response (based on RECIST v1.1 and imRECIST), Disease Control Rate (CR + PR + durable SD) (based on RECIST v1.1), Progression free survival (PFS) (based on RECIST v1.1 and imRECIST), Overall survival (OS)

Source: https://euclinicaltrials.eu/ctis-public/view/2024-513060-26-00